EU clinical trial 2022-503144-40-00: A Phase 3, Randomized, Double-blind, Active Comparator-controlled Clinical Study to Evaluate the Safety, Tolerability, and Immunogenicity of V116 in Pneumococcal Vaccine-naïve Adults 50 Years of Age or Older
Protocol code: V116-010-00
Sponsor: Merck Sharp & Dohme LLC (Pharmaceutical company). Phase: Therapeutic confirmatory (Phase III). Countries: Spain (ended), Germany (ended).
Therapeutic area(s): Diseases [C] - Bacterial Infections and Mycoses [C01]
Gender: Female, Male. Age: 18-64 years, 65+ years. Enrolment: 300.
Status: Ended. Start date (EU): 2022-11-17. End date (EU): 2025-01-30. Decision date: 2023-06-21. Results received: No. Last updated: 2025-01-22.
Decision dates by country: DE: 2023-07-03, ES: 2023-06-21

Condition(s): Pneumococcal disease
Product: Pneumococcal 21-valent Conjugate Vaccine, PNEUMOCOCCUS, PURIFIED POLYSACCHARIDES ANTIGEN

Primary endpoint: Percentage of participants with solicited injection-site AEs, Percentage of participants with solicited systemic AEs, Percentage of participants with vaccine-related serious AE (SAE), Serotype-specific opsonophagocytic (OPA) geometric mean titers (GMTs), Percentage of participants with ≥4-fold rise from baseline in serotype-specific OPAs (unique to V116)
Endpoint(s): Percentage of participants with ≥4-fold rise from baseline in serotype-specific cross-reactive OPAs, Serotype-specific Immunoglobulin G (IgG) geometric mean concentrations (GMCs), Serotype-specific geometric mean fold rise (GMFR) in OPA GMTs, Serotype-specific GMFR in IgG GMCs, Percentage of participants with ≥4-fold rise from baseline in serotype-specific OPA GMTs (all serotypes), Percentage of participants with ≥4-fold rise from baseline in serotype-specific IgG GMCs

Source: https://euclinicaltrials.eu/ctis-public/view/2022-503144-40-00